EU clinical trial 2023-503800-99-00: Intradermal administration of a COVID-19 mRNA vaccine in elderly
Sponsor: Stichting Radboud University Medical Center (Hospital/Clinic/Other health care facility). Phase: Therapeutic exploratory (Phase II). Countries: Netherlands (ended).
Therapeutic area(s): Diseases [C] - Virus Diseases [C02]; Phenomena and Processes [G] - Immune system processes [G12]
Gender: Female, Male. Age: 65+ years. Enrolment: 120.
Status: Ended. Start date (EU): 2023-09-04. End date (EU): 2024-03-21. Decision date: 2023-07-26. Results received: Yes. Last updated: 2023-09-28.

Condition(s): Adult volunteers (M/F) aged ≥75 years who are healthy or have stable disease
Product: Comirnaty Original/Omicron BA.4-5 (15/15 micrograms)/dose dispersion for injection COVID-19 mRNA Vaccine (nucleoside modified)

Primary endpoint: Anti-S IgG levels in serum 28 days after vaccination, expressed in geometric mean concentrations (GMC)
Endpoint(s): SARS-CoV-2 neutralising antibody titres in serum 28 days after vaccination, expressed in geometric mean titres (GMT), The percentage of participants reporting: - Solicited adverse events (AEs) (local reactions, reaction of regional lymph nodes, and systemic reactions up to 14 days following vaccination), unsolicited AEs up to 28 days following vaccination, serious AEs (SAEs) up to 28 days following vaccination and use of antipyretics and analgesics up to 14 days following vaccination.

Source: https://euclinicaltrials.eu/ctis-public/view/2023-503800-99-00